EU clinical trial 2023-509114-11-00: Intra-articular corticosteroid injection vs arthrocentesis in the management of clinical arthritis of the temporomandibular joint: a randomized controlled trial.
Sponsor: Vaestra Goetalandsregionen (Hospital/Clinic/Other health care facility). Phase: Therapeutic use (Phase IV). Countries: Sweden (ongoing, recruiting).
Therapeutic area(s): Diseases [C] - Stomatognathic Diseases [C07]
Gender: Female, Male. Age: 18-64 years, 65+ years. Enrolment: 60.
Status: Ongoing, recruiting. Start date (EU): 2025-11-13. Decision date: 2024-03-22. Results received: No. Last updated: 2024-03-22.

Condition(s): Arthritis of the temporomandibular joint
Product: Natriumklorid B. Braun 9 mg/ml innrennslislyf, lausn, Panodil 500 mg tabletter., Depo-Medrol cum Lidocain 40 mg/ml / 10 mg/ml injektionsvätska, suspension

Primary endpoint: Pain relief will be measured with 100 mm VAS-scale at baseline, 1, 3 and 6 months after treatment
Endpoint(s): The maximal mouth opening will be measured in mm at baseline, 1, 3 and 6 months after treatment with cortisoneinjection or arthrocentesis, Psychosocial factors measurements will be collected at base examination in the clinic and the patients will have to fill out a questionnaire containing The Patient Health Questionnaire (PHQ-9 and PHQ-15), GAD-7, PCS. In every visit JFLS and GCPS will be measured through another questionnaire., Presence of degenerative bone changes will be examined by oral radiologist and graded as 0 (no bony changes) or 1 (bone changes in the TMJ).

Source: https://euclinicaltrials.eu/ctis-public/view/2023-509114-11-00